EU clinical trial 2024-510713-15-00: RT-IMMUNE - A European, multicenter, randomized, open-label, Phase II trial, aiming to assess the clinical and biological activity of an anti-PD-L1 (atezolizumab) in operable localised soft tissue sarcomas patients to be treated with radiotherapy
Protocol code: ET16-132
Sponsor: Centre Leon Berard (Hospital/Clinic/Other health care facility). Phase: Therapeutic exploratory (Phase II). Countries: France (ongoing, recruitment ended).
Therapeutic area(s): Diseases [C] - Neoplasms [C04]
Gender: Female, Male. Age: 18-64 years, 65+ years. Enrolment: 69.
Status: Ongoing, recruitment ended. Start date (EU): 2018-07-30. Decision date: 2024-10-28. Results received: No. Last updated: 2024-10-28.

Condition(s): Localised and operable soft tissue sarcomas
Product: Tecentriq 1 200 mg concentrate for solution for infusion

Primary endpoint: Rate of pathological response defined by at least ≥80% pathologic necrosis on the surgery specimen.
Endpoint(s): - Rate of patients with complete or near-complete pathologic response defined as ≥ 95% tumor necrosis. - Rate of patients with at least ≥ 50% tumor necrosis . - Percentage of residual viable cells. - Objective Response Rate as RECIST v1.1. - Tumor volume change - Quality of resection and amputation rate. - Local Recurrence Rate (LRR) at 1 year post-surgery - Time To Relapse (TTR) - Disease Free Survival (DFS), Evolution of number of T cells (including but not limited to GmzB+/CD8+ T-cell, CD3+), B cells (CD20, IgG), and Treg (FOXP3) on pre (de novo tumor biopsy at baseline) and post-treatment (surgery specimen) by immunofluorescence., Incidene of Adverse Event (AE), Serious Adverse Events (SAEs), AESI and SUSARs.

Source: https://euclinicaltrials.eu/ctis-public/view/2024-510713-15-00